EU clinical trial 2025-521162-10-00: Effect of local 0.5% lidocaine injection in the prevention of acute postoperative pain associated with breast surgery
Sponsor: Consorci Sanitari Integral (Hospital/Clinic/Other health care facility). Phase: Therapeutic use (Phase IV). Countries: Spain (authorised, recruitment pending).
Therapeutic area(s): Analytical, Diagnostic and Therapeutic Techniques and Equipment [E] - Anesthesia and Analgesia [E03]
Gender: Female. Age: 18-64 years, 65+ years. Enrolment: 128.
Status: Authorised, recruitment pending. Decision date: 2025-02-11. Results received: No. Last updated: 2025-02-11.

Condition(s): Disminuir dolor en cirugía de mama
Product: Lidoject 1 % Injektionslösung

Primary endpoint: Dolor agudo postoperatorio a la 1, 4, 12, 24 y 48h postoperatorias (escala EVA), en reposo y en movimiento con la abducción del brazo > 90º

Source: https://euclinicaltrials.eu/ctis-public/view/2025-521162-10-00